EU clinical trial 2024-520177-12-00: A single group treatment, phase 4, study to assess the effect of 1 dose with oxymetazoline nasal spray(Otrivin®) on physical capacity of males and females aged 18 and 64 years suffering from Chronic Obstructive Pulmonary Disease (COPD)
Sponsor: Sorlandet Sykehus HF (Hospital/Clinic/Other health care facility). Phase: Therapeutic confirmatory (Phase III). Countries: Norway (authorised, recruitment pending).
Therapeutic area(s): Diseases [C] - Respiratory Tract Diseases [C08]
Gender: Female, Male. Age: 18-64 years. Enrolment: 64.
Status: Authorised, recruitment pending. Decision date: 2025-01-24. Results received: No. Last updated: 2025-01-24.

Condition(s): Chronic Obstructive Plumonary Disease (COPD)
Product: Nasolin 1 mg/ml nenäsumute, liuos

Primary endpoint: walking distance
Endpoint(s): Borg scale

Source: https://euclinicaltrials.eu/ctis-public/view/2024-520177-12-00